EU clinical trial 2024-517441-14-00: CRYSTAL : Comparison of topical hydrocortisone versus dexamethasone treatment for inflammatory secretions of the conjunctiva in patients with ocular prostheses
Protocol code: 35RC21_8901
Sponsor: Centre Hospitalier Universitaire De Rennes (Hospital/Clinic/Other health care facility). Phase: Phase III and phase IV (Integrated). Countries: France (ongoing, recruiting).
Therapeutic area(s): Diseases [C] - Eye Diseases [C11]; Phenomena and Processes [G] - Ocular Physiological Phenomena [G14]; Phenomena and Processes [G] - Immune system processes [G12]
Gender: Female, Male. Age: 18-64 years, 65+ years. Enrolment: 30.
Status: Ongoing, recruiting. Start date (EU): 2024-10-30. Decision date: 2024-10-30. Results received: No. Last updated: 2025-06-05.

Condition(s): inflammatory secretions of the conjunctiva (Eye desease)
Product: DEXAFREE 1 mg/ml, collyre en solution en récipient unidose, SOFTACORT 3,35 mg/ml, collyre en solution en récipient unidose, DULCILARMES 1,5%, collyre en solution en récipient unidose

Primary endpoint: Secretion Self-Rating Scale score. This 40-point score is calculated as the sum of 4 criteria, each scored on 10 points. (Jacobs et al.; Maucourant et al.)
Endpoint(s): 1) Bulbar conjunctival inflammation score and tarsal conjunctival inflammation score according to the grades of Saini et al., 2) Secretion frequency (score out of 10) according to the secretion analysis scale (Jacobs et al.) - Colour of secretions (score out of 10) according to the secretion analysis scale (Jacobs et al.) - Amount of secretions (score out of 10) according to the secretion analysis scale (Jacobs et al.) - Thickness/Viscosity of secretions (score out of 10) according to the secretion analysis scale (Jacobs et al.), 3) OSDI quality of life score adapted to prosthesis wearers, scored on 40 points (10 items with a maximum of 4 points per item) (Maucourant et al.)

Source: https://euclinicaltrials.eu/ctis-public/view/2024-517441-14-00